EU clinical trial 2024-516279-34-00: The effect of Oxygen sUppleTion on vascular resistance and FLOW: the OUTFLOW study
Protocol code: PaNaMa code: 113071
Sponsor: Stichting Radboud universitair medisch centrum (Hospital/Clinic/Other health care facility). Phase: Therapeutic use (Phase IV). Countries: Netherlands (authorised, recruitment pending).
Therapeutic area(s): Diseases [C] - Respiratory Tract Diseases [C08]; Analytical, Diagnostic and Therapeutic Techniques and Equipment [E] - Therapeutics [E02]; Diseases [C] - Cardiovascular Diseases [C14]; Phenomena and Processes [G] - Circulatory and Respiratory Physiological Phenomena [G09]
Gender: Female, Male. Age: 18-64 years, 65+ years. Enrolment: 24.
Status: Authorised, recruitment pending. Decision date: 2024-10-31. Results received: No. Last updated: 2024-10-31.

Condition(s): Pulmonary Hypertension, Coronary Microvascular Dysfunction, Hypoxia, Heart Failure
Product: Conoxia® Vloeibaar, 100% v/v, medicinaal gas, cryogeen

Primary endpoint: CO (l/min) at 10 minutes after the start of each intervention
Endpoint(s): CO (l/min) at baseline and after 5 minutes of each intervention, Q (ml/min), R (Woods Units), PAWP (mmHg), PVR (mmHg/l/min) and SVR (mmHg/l/min) at baseline and 5 and 10 minutes after each intervention, Epicardial and microvascular vasospasm at 10 minutes after the start of each intervention, Chronological order of changes in CO, Q, R, PAWP, PVR and SVR

Source: https://euclinicaltrials.eu/ctis-public/view/2024-516279-34-00